EU clinical trial 2023-504112-15-00: A Phase 2 Open-label Randomized Study of MORAb-202 (Farletuzumab Ecteribulin), a Folate Receptor Alpha-targeting Antibody-Drug Conjugate, in Participants with Metastatic Non-Small Cell Lung Cancer (NSCLC) Adenocarcinoma (AC) After Progression on Prior Therapies
Protocol code: CA116-003
Sponsor: Bristol Myers Squibb International Corporation (Pharmaceutical company). Phase: Therapeutic exploratory (Phase II). Countries: Spain (ended), France (ended).
Therapeutic area(s): Diseases [C] - Neoplasms [C04]
Gender: Female, Male. Age: 18-64 years, 65+ years. Enrolment: 25.
Status: Ended. Start date (EU): 2023-01-04. End date (EU): 2024-08-12. End date: 2024-08-13. Decision date: 2024-04-24. Results received: Yes. Last updated: 2024-08-21.
Decision dates by country: FR: 2024-04-26, ES: 2024-04-24

Condition(s): Metastatic Non-Small Cell Lung Cancer
Product: farletuzumab ecteribulin

Primary endpoint: Incidence and severity of adverse events (AEs)/serious AEs (SAEs), treatment related AEs/SAEs, AEs leading to discontinuation, AEs of special interest (AESI), deaths and laboratory abnormalities. Incidence of treatment-related adverse events (TRAEs) leading to study treatment discontinuation
Endpoint(s): Incidence and severity of adverse events (AEs)/serious AEs (SAEs), treatment related AEs/SAEs, AEs of special interest (AESI), deaths and laboratory abnormalities., PFS by RECIST 1.1 per investigator assessment

Source: https://euclinicaltrials.eu/ctis-public/view/2023-504112-15-00